EU clinical trial 2024-519275-26-00: A phase I-II, multicentre, open label clinical trial to assess the safety and tolerability of the combination of low-dose cytarabine or azacitidine, plus Venetoclax and Quizartinib in newly diagnosed acute myeloid leukemia patients aged equal or more than 60 years old ineligible for standard induction chemotherapy
Protocol code: VEN-A-QUI
Sponsor: Fundacion PETHEMA (Patient organisation/association). Phase: Phase I and Phase II (Integrated)- Other. Countries: Spain (ended).
Therapeutic area(s): Diseases [C] - Neoplasms [C04]
Gender: Female, Male. Age: 18-64 years, 65+ years. Enrolment: 84.
Status: Ended. Start date (EU): 2024-11-15. End date (EU): 2025-09-30. Decision date: 2024-11-15. Results received: Yes. Last updated: 2025-02-25.

Condition(s): Newly diagnosed acute myeloid leukemia patients aged equal or more than 60 years old
Product: Quizartinib, QUIZARTINIB DIHYDROCHLORIDE, Venclyxto 100 mg film-coated tablets, Venclyxto 50 mg film-coated tablets, Venclyxto 10 mg film-coated tablets, Quizartinib

Primary endpoint: Phase I: Recommended phase 2 dose (RP2D) of AZA based and LDAC based triple combination with Quizartinib and Venetoclax schedules -Phase II: CR/CRi rate of AZA based and LDAC based triple combination with Quizartinib and Venetoclax schedules
Endpoint(s): CR/CRi rate after 1, and 4 cycles, Overall survival (OS), Safety and tolerability of the AZA based and LDAC based triple combination with Quizartinib and Venetoclax schedules (overall hematologic and non-hematologic toxicity), Event-free survival (EFS), Disease-free survival (DFS), Relapse-free survival (RFS), Quality of life (from the EuroQoL Group EQ-5D-5L and the EORTC QLQ-C30 instruments), Medical resources during treatment phase, Minimal residual disease (MRD), CRh rate (Bone marrow blasts <5% with partial hematologic recovery defined as ANC ≥0.5 × 109/L and platelet count ≥50 × 109/L, with no evidence of extramedullary leukemia and cannot be classified as CR), Early mortality (first 30 and 60 days), Separate analyses in secondary AML, CBF, FLT3-ITD, NPM1, P53, and IDH1/IDH2 subsets., Exploration of biomarkers predictive of drug activity and duration of response. Potential analyses may include: o To evaluate the MRD negativity rate in the BM using MPFC and NGS o Immune recovery o Exhaustive biomarker plan including baseline and relapse molecular characterization by NGS

Source: https://euclinicaltrials.eu/ctis-public/view/2024-519275-26-00